EU clinical trial 2024-512313-41-00: A Randomized, Double-blind, Placebo-controlled, Three-arm Parallel-group, Multi-centre Phase III Clinical Study to Confirm the Anti-anginal Effect of T89 in Patients with Stable Angina (ORESA Study)
Protocol code: T89-08-ORESA
Sponsor: Tasly Pharmaceuticals Inc. (Pharmaceutical company). Phase: Therapeutic confirmatory (Phase III). Countries: Bulgaria (temporarily halted), Slovakia (temporarily halted), Romania (temporarily halted), Poland (temporarily halted).
Therapeutic area(s): Diseases [C] - Cardiovascular Diseases [C14]
Gender: Female, Male. Age: 18-64 years, 65+ years. Enrolment: 690.
Status: Temporarily halted. Start date (EU): 2025-05-19. Decision date: 2024-11-05. Results received: No. Last updated: 2026-02-23.
Decision dates by country: SK: 2024-11-05, PL: 2024-12-12, BG: 2024-11-05, RO: 2024-11-11

Condition(s): Stable Angina Pectoris
Product: T89 Placebo; capsules contain brown coated dripping pills., Nitroglycerin Orifarm 0,5 mg tabletes lietošanai zem mēles

Primary endpoint: Efficacy endpoint: Change in symptom-limited total exercise duration (TED) at trough drug levels on standard Bruce protocol from baseline to Day 57., Safety endpoints: Frequency and severity of adverse events and serious adverse events, Safety endpoints: Notable laboratory abnormalities which are treatment-emergent
Endpoint(s): Efficacy endpoints: The trend of TED changes over time (Slope) from Day 1 to Day 57., Percent change in the average frequency of angina episodes (average over 14 days) from baseline [Day -14 to 1] to the end of double-blind treatment period [Day 43 to 57]., Percent change in the average on-demand consumption of short-acting nitroglycerin (average over 14 days) from baseline [Day -14 to 1] to end of double-blind treatment period [Day 43 to 57]., Change in symptom-limited total exercise duration (TED) at trough drug levels on standard Bruce protocol from baseline to Day 43;, Percent change in the average frequency of angina episodes (average over 14 days) from baseline [Day -14 to 1] to the end of double-blind treatment period [Day 29 to 43]., Change in time to the onset of angina during ETT from baseline to Day 57, Change in time to the onset of 1 mm ST depression during ETT from baseline to Day 57

Source: https://euclinicaltrials.eu/ctis-public/view/2024-512313-41-00